EU clinical trial 2023-506229-12-00: A phase II, randomized, open-label study to assess the efficacy, safety, and pharmacokinetics (PK) of maintenance cabozantinib (XL184) plus best supportive care (BSC) versus BSC in children, adolescents and young adults (AYA) with unresectable residual osteosarcoma either at diagnosis or at first relapse after standard treatment.
Protocol code: CLIN-60000-461
Sponsor: Ipsen Innovation (Pharmaceutical company). Phase: Therapeutic exploratory (Phase II). Countries: Poland (ended), France (ended), Netherlands (ended), Sweden (ended), Italy (ended), Spain (ended), Denmark (ended), Ireland (ended), Belgium (ended), Germany (ended), Austria (ended).
Therapeutic area(s): Diseases [C] - Neoplasms [C04]
Gender: Female, Male. Age: 0-17 years, 18-64 years. Enrolment: 86.
Status: Ended. Start date (EU): 2024-06-26. End date (EU): 2026-02-27. End date: 2026-02-28. Decision date: 2024-06-03. Results received: No. Last updated: 2026-03-04.
Decision dates by country: AT: 2024-09-09, BE: 2024-08-26, SE: 2024-06-03, DK: 2024-08-30, FR: 2024-06-05, PL: 2024-06-10, IE: 2024-09-06, NL: 2024-06-03, ES: 2024-06-04, IT: 2024-06-04, DE: 2024-08-29

Condition(s): Osteosarcoma in Children, Osteosarcoma in Adolescents and Young Adults, Osteosarcoma
Product: CABOMETYX 20 mg film-coated tablets, CABOMETYX 60 mg film-coated tablets

Primary endpoint: Progression-free Survival (PFS) assessed by Blinded Independent Radiology Committee (BIRC) PFS defined as the time from the date of randomization to the date of first documented disease progression or the date of death due to any cause, whichever occurs first. Time Frame: From randomization until disease progression or death from any cause, whichever occurs first (approximately 34 months)
Endpoint(s): Progression-free survival (PFS) rate assessed by BIRC: PFS rate at 4 months and 1 year was defined as the probability that participants have not progressed by BIRC assessment and remain alive at 4 months and 1 year. Time Frame: 4 months and 1 year after randomization, Objective response rate (ORR) assessed by BIRC: ORR defined as the proportion of participants who have achieved complete response (CR) or partial response (PR) determined by BIRC. Time Frame: Approximately 34 months after randomization, Disease control rate (DCR) assessed by BIRC: Defined as the proportion of participants who have achieved CR, PR, or stable disease (SD) determined by BIRC. Time Frame: Approximately 34 months after randomization, PFS assessed by investigator: Defined as the time from the date of randomization to the date of first documented disease progression determined by investigator or the date of death due to any cause, whichever occurs first. Time Frame: From randomization until disease progression or death from any cause, whichever occurs first (approximately 34 months), PFS rate assessed by investigator: Defined as the probability that participants have not progressed by investigator assessment and remain alive at 4 months and 1 year.Time Frame: At 4 months and 1 year after randomization, ORR assessed by investigator: Defined as the proportion of participants who have achieved complete response (CR) or partial response (PR) determined by investigator using RECIST version 1.1. Time Frame: Approximately 34 months after randomization, DCR assessed by investigator Defined as the proportion of participants who have achieved CR, PR, or SD determined by investigator. Time Frame: Approximately 34 months after randomization, Overall survival (OS): Defined as the time from date of randomization to the date of death, from any cause. Time Frame: From randomization until death or last contact (approximately 34 months), Overall survival (OS): Defined as the probability participants alive at 1 year. Time Frame: At 1 year after randomization, Percentage of participants with Treatment Emergent Adverse Event (TEAEs) and Adverse Events of Special Interest (AESIs). [Time Frame: From screening till 30 days after last dose for AE, and until resolution or stabilization for treatment related SAE], Area Under Curve (AUC) at steady state. Time Frame: At Cycle 1 Day 1 and Cycle 2 Day 1, Average concentration (Cavg) at steady state. Time Frame: Time Frame: At Cycle 1 Day 1 and Cycle 2 Day 1, Minimum concentration (Cmin) at steady state. Time Frame: Time Frame: At Cycle 1 Day 1 and Cycle 2 Day 1, Maximal concentration (Cmax) at steady state. Time Frame: Time Frame: At Cycle 1 Day 1 and Cycle 2 Day 1, Acceptability and palatability in children and adolescents assessed using a horizontal visual assessment scale. Five-point facial hedonic scale with a correlated 100-point horizontal visual analog scale (FHS/VAS-5) will be used to assess acceptability and palatability in children and adolescents. Time Frame: Day of first dose, . Change from baseline in score for all Paediatric QoL Inventory (PedsQL) Scales including Generic Core Scales and Cancer Modules. [Time Frame: From screening to 30 days after last dose], Change from baseline in EORTC QLQ-C30 for adult participants. [Time Frame: From screening to 30 days after last dose]

Source: https://euclinicaltrials.eu/ctis-public/view/2023-506229-12-00